EU clinical trial 2022-500030-28-01: C5731002 - A Phase 2 Multi-Cohort, Open-Label, Multi-Center Clinical Study Evaluating the Efficacy and Safety of Disitamab Vedotin (RC48-ADC) Alone or in Combination with Pembrolizumab in Subjects with Locally-Advanced Unresectable or Metastatic Urothelial Carcinoma That Expresses HER2
Protocol code: RC48G001
Sponsor: Seagen Inc. (Pharmaceutical company). Phase: Therapeutic exploratory (Phase II). Countries: Belgium (ongoing, recruitment ended), Spain (ongoing, recruitment ended), France (not authorised), Italy (ongoing, recruitment ended).
Therapeutic area(s): Diseases [C] - Neoplasms [C04]
Gender: Female, Male. Age: 18-64 years, 65+ years. Enrolment: 14.
Start date (EU): 2024-06-10. Decision date: 2024-04-24. Results received: No. Last updated: 2026-05-26.
Decision dates by country: FR: 2024-04-29, IT: 2024-04-29, BE: 2024-04-24, ES: 2024-04-24

Condition(s): Urothelial carcinoma
Product: Disitamab Vedotin

Primary endpoint: cORR (confirmed CR and confirmed PR) per RECIST v1.1 as assessed by BICR, cORR per RECIST v1.1 as assessed by BICR
Endpoint(s): cORR per RECIST v1.1, as assessed by the investigator, Confirmed DOR per RECIST v1.1, as assessed by BICR ● Confirmed DOR per RECIST v1.1, as assessed by the investigator, PFS per RECIST v1.1, as assessed by BICR ● PFS per RECIST v1.1, as assessed by the investigator, DCR (confirmed CR, confirmed PR, and stable disease) per RECIST v1.1, as assessed by BICR ● DCR per RECIST v1.1, as assessed by the investigator, OS, Type, incidence, relatedness, severity and seriousness of AEs ● Treatment discontinuations, dose reductions, or dose delays due to AEs ● Type, incidence and severity of laboratory abnormalities ● ECG abnormalities, including changes in QTc ● Effect on LVEF, PK parameters of disitamab vedotin, free MMAE, and TAb, Incidence of ADA and NABs against disitamab vedotin

Source: https://euclinicaltrials.eu/ctis-public/view/2022-500030-28-01